EU clinical trial 2026-525478-21-00: A randomized, multiple ascending doses, clinical trial to evaluate safety, tolerability, pharmacokinetics, and pharmacodynamics of CV-01 after double-blind, placebo-controlled multiple oral administrations for 2 weeks in healthy volunteers, and multiple oral administrations open-label for 2 weeks in a cohort of participants with drug resistant epilepsy
Protocol code: 175(A)MD25105
Sponsor: Angelini Pharma Italia Aziende Chimiche Riunite Angelini Francesco A.C.R.A.F. S.p.A. Enunciabile Anche Angelini Pharma Italia S.p.A. Angelini Pharma S.p.A. A.C.R.A.F. S.p.A. Acraf S.p.A. Angelini S.p.A. aziende Chimiche Riunite Angelini Francesco A.C.R.A.F. S.p.A. (Pharmaceutical company). Phase: Human Pharmacology (Phase I)- Other. Countries: Sweden (authorised, recruitment pending).
Therapeutic area(s): Diseases [C] - Nervous System Diseases [C10]
Gender: Female, Male. Age: 18-64 years, 65+ years. Enrolment: 36.
Status: Authorised, recruitment pending. Decision date: 2026-06-08. Results received: No. Last updated: 2026-06-08.

Condition(s): Drug resistant epilepsy

Source: https://euclinicaltrials.eu/ctis-public/view/2026-525478-21-00